EU clinical trial 2025-522269-30-00: Normothermic intraperitoneal chemotherapy (NIPEC) with carboplatin following cytoreductive surgery in elderly and fragile ovarian cancer patients: a feasibility study
Sponsor: Odense University Hospital (Hospital/Clinic/Other health care facility). Phase: Therapeutic exploratory (Phase II). Countries: Denmark (ongoing, recruiting).
Therapeutic area(s): Analytical, Diagnostic and Therapeutic Techniques and Equipment [E] - Therapeutics [E02]; Diseases [C] - Female Urogenital Diseases and Pregnancy Complications [C13]; Analytical,Diagnostic,Therapeutic Techniques and Equipment [E]-Surgical Procedures, Operative [E04]
Gender: Female. Age: 65+ years. Enrolment: 10.
Status: Ongoing, recruiting. Start date (EU): 2026-04-07. Decision date: 2025-12-22. Results received: No. Last updated: 2026-04-07.

Condition(s): Ovarian cancer
Product: CARBOPLATIN

Primary endpoint: Safety of the treatment of cytoreductive surgery combined with Normothermic Intraperitoneal Chemotherapy with carboplatin: The proportions of patients experiencing perioperative and postoperative complications of adverse events (AEs) of grade 3 to 5 according to the Common Terminology for Adverse Events (CTCAE) version 5.0 and Clavien-Dindo classification (surgical AEs) together with adverse drug reactions (ADRs) related to carboplatin until the day of adjuvant chemotherapy start.
Endpoint(s): Length of hospital stay., Proportion of reoperations and cause., Proportion of readmissions and cause., Time from surgery to the first dose of adjuvant systemic chemotherapy., Proportion of participants completing the adjuvant chemotherapy of three cycles., Feasibility according to patients willing to participate in the trial., PROs on QoL assessed by questionnaires., Costs of NIPEC in addition to standard treatment., Carboplatin local peritoneal tissue and systemic plasma pharmacokinetics measured using microdialysis., Local peritoneal tissue and systemic response using inflammation protein markers, ischemic metabolites and histology. The local response will be assessed in both macroscopic healthy peritoneal tissue and tumour nodules less than 1 cm.

Source: https://euclinicaltrials.eu/ctis-public/view/2025-522269-30-00